EU clinical trial 2023-506375-10-00: A study to test whether multiple doses of BI 456906 have an effect on cardiac safety in people with overweight or obesity.
Protocol code: 1404-0011
Sponsor: Boehringer Ingelheim International GmbH (Pharmaceutical company). Phase: Human Pharmacology (Phase I)- Other. Countries: Germany (ended).
Therapeutic area(s): Not possible to specify
Gender: Female, Male. Age: 18-64 years. Enrolment: 110.
Status: Ended. Start date (EU): 2024-03-04. End date (EU): 2025-10-22. Decision date: 2024-01-12. Results received: No. Last updated: 2024-10-09.

Condition(s): Healthy volunteer trial

Source: https://euclinicaltrials.eu/ctis-public/view/2023-506375-10-00